EU clinical trial 2023-507892-23-00: A Phase 2a, Randomised, Double-Blind, Placebo-Controlled Study to Evaluate the Efficacy, Safety, and Tolerability of NMD670 over 21 days in Ambulatory Adult Patients with Charcot-Marie-Tooth Disease Type 1 and Type 2
Protocol code: NMD670-02-0003
Sponsor: NMD Pharma A/S (Pharmaceutical company). Phase: Therapeutic exploratory (Phase II). Countries: Spain (ended), Belgium (ended), France (ended), Denmark (ended).
Therapeutic area(s): Diseases [C] - Nervous System Diseases [C10]
Gender: Female, Male. Age: 18-64 years, 65+ years. Enrolment: 52.
Status: Ended. Start date (EU): 2024-08-30. End date (EU): 2025-10-09. End date: 2025-11-05. Decision date: 2024-07-11. Results received: No. Last updated: 2025-09-02.
Decision dates by country: FR: 2024-07-12, DK: 2024-07-11, BE: 2024-07-17, ES: 2024-07-12

Condition(s): Charcot-Marie-Tooth Disease Type 1 and Type 2
Product: NMD670, Placebo

Primary endpoint: Change from baseline to day 21 in the total distance walked during the 6MWT for NMD670 vs placebo.

Source: https://euclinicaltrials.eu/ctis-public/view/2023-507892-23-00